EU clinical trial 2022-500628-31-00: A Phase 2 Study of Intratumoral Injection of LTX-315 in Combination with Pembrolizumab in Patients with Percutaneously Accessible Lesions with Advanced Melanoma Refractory to PD-1/PD-L1 Inhibitor Therapy
Protocol code: C20-315-05
Sponsor: Lytix Biopharma AS (Pharmaceutical company). Phase: Therapeutic exploratory (Phase II). Countries: France (ended), Norway (ended), Spain (ended).
Therapeutic area(s): Diseases [C] - Neoplasms [C04]
Gender: Female, Male. Age: 18-64 years, 65+ years. Enrolment: 22.
Status: Ended. Start date (EU): 2022-10-24. End date (EU): 2025-06-13. End date: 2025-07-01. Decision date: 2022-08-26. Results received: Yes. Last updated: 2024-03-11.
Decision dates by country: FR: 2022-08-26, ES: 2022-08-31, NO: 2022-09-05

Condition(s): Advanced Melanoma
Product: CIMETIDINE, CHLORPHENAMINE, MONTELUKAST, KEYTRUDA 25 mg/mL concentrate for solution for infusion

Primary endpoint: ORR, defined as the proportion of patients who achieved PR and/or CR per local Investigator assessment using RECIST version 1.1, CBR, defined as the proportion of patients who respond to treatment, estimated as the proportion of patients who achieve SD, PR, or CR per local Investigator assessment using iRECIST., OS, evaluated as time from baseline until death.
Endpoint(s): incidence and severity of AEs (including physical examination findings) related to LTX 315 or to the combination of LTX-315 and pembrolizumab from baseline to end of treatment, incidence of clinical laboratory abnormalities based on clinical chemistry, hematology, urinalysis, and coagulation test results, change from baseline in vital signs measurements (pulse rate, body temperature, respiration rate), change from baseline in blood pressure measurements, change from baseline in 12-lead ECG parameters, including QT interval corrected for heart rate using Fridericia’s formula (QTcF), incidence of LTX-315 injection site assessment findings (injection site pain, swelling, and redness).

Source: https://euclinicaltrials.eu/ctis-public/view/2022-500628-31-00